EU clinical trial 2022-503014-23-00: Postauthorization Safety Study of the Long-Term Safety and Efficacy of Repeat Administration of Darvadstrocel in Patients With Crohn’s Disease and Complex Perianal Fistula
Protocol code: Alofisel-4001
Sponsor: Takeda Development Center Americas Inc. (Pharmaceutical company). Phase: Therapeutic use (Phase IV). Countries: Austria (ended), Spain (ended), Czechia (ended), France (ended), Germany (ended).
Therapeutic area(s): Diseases [C] - Digestive System Diseases [C06]
Gender: Female, Male. Age: 18-64 years, 65+ years. Enrolment: 45.
Status: Ended. Start date (EU): 2020-06-03. End date (EU): 2025-02-14. End date: 2025-02-15. Decision date: 2023-12-18. Results received: Yes. Last updated: 2025-03-31.
Decision dates by country: FR: 2023-12-22, DE: 2023-12-20, CZ: 2023-12-20, ES: 2023-12-19, AT: 2023-12-18

Condition(s): Perianal fistulising Crohn´s disease
Product: Alofisel 5 × 106 cells/mL dispersion for injection.

Primary endpoint: • Treatment-emergent AEs • Treatment-emergent SAEs • Pregnancy • Specific treatment-emergent AESIs: immunogenicity/alloimmune reactions; hypersensitivity; transmission of infectious agents; tumorgenicity, applying to malignant tumors only; ectopic tissue formation; medication errors (reported to the pharmacovigilance department as special situation reports)
Endpoint(s): Proportion of subjects achieving combined remission of perianal fistulas at Weeks 24 and 156 after darvadstrocel repeat administration. Combined remission is defined as: closure of all treated external openings that were draining at baseline, despite gentle finger compression, AND absence of collections >2cm (in at least 2 dimensions) of the treated perianal fistulas confirmed by centrally read MRI., Proportion of subjects who achieve clinical remission at Weeks 6, 24, 52, 104, and 156 after darvadstrocel repeat administration. Clinical remission is defined as closure of all treated external fistula openings that were draining at baseline despite gentle finger compression., Proportion of subjects who achieve clinical response at Weeks 6, 24, 52, 104, and 156 after darvadstrocel repeat administration. Clinical response is defined as closure of at least 50% of all treated external fistula openings that were draining at baseline despite gentle finger compression., Proportion of subjects with relapse from Week 24 combined remission, where relapse is defined as: a) Reopening of any of the treated fistula(s) external openings with active draining as clinically assessed, thatwere in combined remission at Week 24, OR b) The development of a collection >2 cm (in at least 2 dimensions) of the treated perianal fistula(s) confirmed by centrally read MRI assessment., Time to reopening of any of the treated external openings with active drainage as clinically assessed, measured in days relative to Week 24., Proportion of subjects with new perianal abscess in treated fistula., Change from baseline to Weeks 6, 24, 52, 104, and 156 after darvadstrocel repeat administration in scores of discharge and pain items of Perianal Disease Activity Index (PDAI) score.

Source: https://euclinicaltrials.eu/ctis-public/view/2022-503014-23-00